EU clinical trial 2023-505902-40-00: J3E-MC-EZDB: A Phase 2, Randomized, Double-Blind, Placebo-Controlled Study to Investigate the Efficacy and Safety of LY3540378 in Adults with Worsening Chronic Heart Failure with Preserved Ejection Fraction (HFpEF)
Protocol code: J3E-MC-EZDB
Sponsor: Eli Lilly & Co. (Pharmaceutical company). Phase: Therapeutic exploratory (Phase II). Countries: Hungary (ended), Poland (ended), Spain (ended), Czechia (ended).
Therapeutic area(s): Diseases [C] - Cardiovascular Diseases [C14]
Gender: Female, Male. Age: 18-64 years, 65+ years. Enrolment: 195.
Status: Ended. Start date (EU): 2023-03-28. End date (EU): 2024-11-19. Decision date: 2024-01-16. Results received: Yes. Last updated: 2026-06-29.
Decision dates by country: HU: 2024-01-16, ES: 2024-01-24, CZ: 2024-11-11, PL: 2024-03-25

Condition(s): Heart Failure, Heart Failure with Preserved Ejection Fraction
Product: Placebo to match LY3540378

Primary endpoint: Change from Baseline in Left Atrial Reservoir Strain (LARS)

Source: https://euclinicaltrials.eu/ctis-public/view/2023-505902-40-00